EU clinical trial 2024-513927-18-00: A Phase 2, Randomized, Double-Blind, Double-Dummy Study Evaluating the Efficacy, Safety and Biomarkers Effect of ILB® versus Riluzole in participants with Amyotrophic Lateral Sclerosis
Sponsor: Oslo University Hospital HF (Hospital/Clinic/Other health care facility). Phase: Therapeutic exploratory (Phase II). Countries: Norway (ongoing, recruiting).
Therapeutic area(s): Diseases [C] - Nervous System Diseases [C10]
Gender: Female, Male. Age: 18-64 years, 65+ years. Enrolment: 116.
Status: Ongoing, recruiting. Start date (EU): 2026-02-16. Decision date: 2025-04-25. Results received: No. Last updated: 2026-06-24.

Condition(s): Amyotrophic Lateral Sclerosis
Product: ILB, RILUTEK 50 mg film-coated tablets, Placebo for ILB, Placebo Riluzole capsules

Primary endpoint: The change in Amyotrophic Lateral Sclerosis Functional Rating Scale (revised) (ALSFRS-R) score from baseline at week 24
Endpoint(s): Change in Serum Nfl from baseline to week 24, The change in the concentration of Extracellular domain of p75(P75ECD) in urine from baseline at week 24, The change in serum N-acetyl-aspartate (NAA) concentration from baseline at week 24, The change in Modified Norris Scale scores from baseline at week 24, The change in forced vital capacity (FVC) scores from baseline at week 24, Incidence and severity of adverse events (AEs) and serious AEs (SAEs), Clinically meaningful changes in laboratory parameters, vital signs, and electrocardiogram (ECG) results, The change from baseline in Edinburgh Cognitive and Behavioral ALS screen (ECAS) scores at week 24, The change in mean scores as measured by Amyotrophic Lateral Sclerosis Assessment Questionnaire (ALSAQ-40) and EuroQol-5-Dimension-5-Levels questionnaire (EQ-5D-5L) questionnaire from baseline at week 24, PK parameters of ILB® in approximately 10 participants, The change from baseline of serum Nfl, NAA and P75ECD in urine at week 48, The mean change from baseline in ALSFRS-R score, Modified Norris Scale scores, FVC scores, ECAS score, ALSAQ-40 and EQ-5D-5L at week 48, OS is assessed by time from baseline to death from any cause or tracheostomy, whichever comes first, Measure biomarker activity changes of e.g. Interleukin-6 (IL-6), HGF and glutamate from baseline to week 24 and to week 48, MRI changes from baseline at week 24 and week 48 in selected 50 participants with ALS, Healthcare utilization data, including hospital stays and emergency room (ER) visits, will be collected. HRQOL will be assessed with ALSAQ-40 and EQ-5D-5L. Economic analysis will assess changes in healthcare usage using both within-trial and model-based approaches, with an emphasis on long-term projections. Study-required procedures are excluded

Source: https://euclinicaltrials.eu/ctis-public/view/2024-513927-18-00